EU clinical trial 2025-522583-32-00: A Phase 3 Randomized, Double-Blind, Placebo-Controlled, Multi-Center, Parallel-Group Study of Barzolvolimab in Participants with Cold Induced Urticaria and Symptomatic Dermographism (EMBARQ-COLDU and SD)
Protocol code: CDX0159-16
Sponsor: Celldex Therapeutics Inc. (Pharmaceutical company). Phase: Therapeutic confirmatory (Phase III). Countries: Germany (ongoing, recruiting), Lithuania (ongoing, recruiting), Spain (ongoing, recruiting), Poland (ongoing, recruiting).
Therapeutic area(s): Diseases [C] - Skin and Connective Tissue Diseases [C17]
Gender: Female, Male. Age: 18-64 years, 65+ years. Enrolment: 126.
Status: Ongoing, recruiting. Start date (EU): 2026-04-13. Decision date: 2026-03-25. Results received: No. Last updated: 2026-08-03.
Decision dates by country: LT: 2026-03-25, DE: 2026-03-25, ES: 2026-03-27, PL: 2026-03-27

Condition(s): Cold-Induced Urticaria and Symptomatic Dermographism
Product: FASTJEKT 300 Mikrogramm, Injektionslösung im Fertigpen, BARZOLVOLIMAB, Placebo prefilled syringes containing only the vehicle (containing 0 mg/mL barzolvolimab).

Primary endpoint: • ColdU: Proportion of participants with complete response in Critical Temperature Threshold (CTT) following the TempTest® 4.0 at Week 12 • SD: Proportion of participants with complete response in Critical Friction Threshold (CFT) following the FricTest® 4.0 at Week 12
Endpoint(s): • ColdU: Change from baseline in CTT following the TempTest® at Week 12 • SD: Change from baseline in CFT following the FricTest® at Week 12, • ColdU: Proportion of participants with complete response in CTT following the TempTest® at Week 24 • SD: Proportion of participants with complete response in CFT following FricTest® at Week 24, • ColdU: Change from baseline in CTT following the TempTest® at Week 24 • SD: Change from baseline in CFT following the FricTest® at Week 24", • ColdU: Change from baseline in worst itch-numeric rating scale (WI-NRS) at Week 12 • SD: Change from baseline in worst itch-numeric rating scale (WI-NRS) at Week 12, • ColdU: Change from baseline in WI-NRS at Week 24 • SD: Change from baseline in WI-NRS at Week 24, • ColdU: Change from baseline in WI-NRSprovo following the TempTest® at Week 12 • SD: Change from baseline in WI-NRSprovo following the FricTest® at Week 12, • ColdU: Proportion of participants with complete response in CTT following the TempTest® at Week 4 • SD: Proportion of participants with complete response in CFT following FricTest® at Week 4, • ColdU: Change from baseline in CTT following the TempTest® at Week 4 • SD: Change from baseline in CFT following the FricTest® at Week 4, • ColdU: Change from baseline in worst hives-numeric rating scale (WH-NRS) at Week 12 • SD: Change from baseline in WH-NRS at Week 12, • ColdU: Change from baseline in WH-NRS at Week 24 • SD: Change from baseline in WH-NRS at Week 24, • ColdU: Proportion of participants with DLQI = 0-1 at Week 12 • SD: Proportion of participants with DLQI = 0-1 at Week 12, • Safety endpoints will include but not be limited to: • Incidence of treatment-emergent adverse events • Incidence of treatment-emergent serious adverse events • Incidence of treatment-emergent adverse events of special interest

Source: https://euclinicaltrials.eu/ctis-public/view/2025-522583-32-00